EU clinical trial 2022-500700-22-00: A Phase 3, Randomized, Double-Blind, Placebo-Controlled Study to Evaluate the Efficacy and Safety of Deucravacitinib in Participants with Active Systemic Lupus Erythematosus (SLE) (POETYK SLE-2)
Protocol code: IM011247
Sponsor: Bristol-Myers Squibb Services Unlimited Company (Pharmaceutical company). Phase: Therapeutic confirmatory (Phase III). Countries: Hungary (ongoing, recruitment ended), Czechia (ongoing, recruitment ended), Portugal (ongoing, recruitment ended), Spain (ongoing, recruitment ended), Poland (ongoing, recruitment ended), Bulgaria (ongoing, recruitment ended), Greece (ongoing, recruitment ended).
Therapeutic area(s): Diseases [C] - Immune System Diseases [C20]
Gender: Female, Male. Age: 18-64 years, 65+ years. Enrolment: 147.
Status: Ongoing, recruitment ended. Start date (EU): 2023-05-25. Decision date: 2023-04-28. Results received: No. Last updated: 2026-06-15.
Decision dates by country: GR: 2023-10-19, CZ: 2023-05-02, ES: 2023-04-28, BG: 2023-10-16, PT: 2023-05-02, HU: 2023-05-02, PL: 2023-05-05

Condition(s): Active Systemic Lupus Erythematosus (SLE)
Product: deucravacitinib, Deucravacitinib placebo film-coated tablets oral use

Primary endpoint: Proportion of participants who achieve SRI(4) response at Week 52
Endpoint(s): Proportion of participants who achieve BICLA response at Week 52. Proportion of participants who achieve both SRI(4)and BICLA (dual responders) at Week 52., Proportion of participants with a Cutaneous Lupus Erythematosus Disease Area and Severity Index (CLASI) activity score ≥ 10 at baseline who achieve a CLASI response, defined as a decrease of ≥ 50% from baseline CLASI activity score at Week 52. Proportion of participants who achieve LLDAS at Week 52., Proportion of participants with OCS ≥ 7.5 mg/day of prednisone (or equivalent) at baseline who are receiving ≤ 5 mg/day of prednisone (or equivalent) at Week 40 which is maintained through Week 52 and who achieve an SRI(4) response at Week protocol- specified limits to Week 52. Proportion of participants with ≥ 6 active (tender+ swollen) joints at baseline who achieve at least 50% from baseline reduction in active (tender + swollen) joints at Week 52., Change from baseline in patient-reported fatigue according to FACIT-Fatigue at Week 52. Incidence of AEs, SAEs, AEs leading to discontinuation of treatment and study discontinuation, and target AESIs; change from baseline and/or abnormalities in laboratory, electrocardiogram (ECG), and vital signs

Source: https://euclinicaltrials.eu/ctis-public/view/2022-500700-22-00